EU clinical trial 2024-511977-31-01: 68Ga-FAPI-46 PET for Giant Cell Arteritis-Polymyalgia Rheumatica Spectrum Disease
Sponsor: Universitair Medisch Centrum Groningen (Hospital/Clinic/Other health care facility). Phase: Therapeutic exploratory (Phase II). Countries: Netherlands (authorised, recruitment pending).
Therapeutic area(s): Diseases [C] - Cardiovascular Diseases [C14]; Diseases [C] - Musculoskeletal Diseases [C05]; Diseases [C] - Immune System Diseases [C20]
Gender: Female, Male. Age: 18-64 years, 65+ years. Enrolment: 30.
Status: Authorised, recruitment pending. Decision date: 2026-04-14. Results received: No. Last updated: 2026-04-14.

Condition(s): giant cell arteritis - polymyalgia rheumatica spectrum disease
Product: [68Ga]FAPI-46

Primary endpoint: The diagnostic accuracy of 68Ga-FAPI-46 PET/CT in patients with suspected GPSD.
Endpoint(s): 68Ga-FAPI-46 uptake after 28 days of standard treatment in patients with GPSD., 68Ga-FAPI-46 uptake after 6 months of standard treatment in patients with GPSD

Source: https://euclinicaltrials.eu/ctis-public/view/2024-511977-31-01